EU clinical trial 2024-517300-10-01: Preventive HIPEC in combination with perioperative FLOT versus FLOT alone for resectable diffuse type gastric and gastroesophageal junction Type II/III adenocarcinoma – The phase III “PREVENT” trial of the AIO /CAOGI /ACO
Protocol code: HIPEC/FLOT9
Sponsor: Krankenhaus Nordwest GmbH (Hospital/Clinic/Other health care facility). Phase: Therapeutic confirmatory (Phase III). Countries: Germany (ongoing, recruiting).
Therapeutic area(s): Diseases [C] - Neoplasms [C04]
Gender: Female, Male. Age: 18-64 years, 65+ years. Enrolment: 200.
Status: Ongoing, recruiting. Start date (EU): 2020-12-17. Decision date: 2024-10-29. Results received: No. Last updated: 2026-06-03.

Condition(s): Resectable diffuse type gastric and gastroesophageal junction Typ II/III adenocarcinoma
Product: DOCETAXEL, OXALIPLATIN, FLUOROURACIL, CALCIUM FOLINATE, CISPLATIN

Primary endpoint: PFS/DFS, defined as the time from randomization to disease progression or relapse after surgery or death from any cause. If no event is observed PFS/DFS is censored at the time of last tumor assessment.
Endpoint(s): OS, defined as the time from randomization to death from any cause If no event is observed OS is censored at the day of last subject contact., Rate of patients with peritoneal relapse at 2 and 3 years in both arms., PFS/DFS rates at 2, 3 & 5 years defined as the percentage of patients without disease progression or relapse after surgery or death from any cause after 2, 3 and 5 years referring to the total number of patients randomized into the respective treatment arm., OS rates at 3 & 5 years defined as the percentage patients known to be alive after 3 and 5 years referring to the total number of patients randomized into the respective treatment arm., Rate of surgical serious adverse events, according to National Cancer Institute Common Terminology Criteria for Adverse Events (NCI CTCAE Version 5.0) grade ≥ 3 adverse events and grade ≥ 3 laboratory toxicities., OS and PFS/DFS (medians and rates) according to subgroup (diffuse vs. mixed and gastric vs. GEJ type II/III)., Quality of life (QoL) – EORTC QLQ C30 and EORTC QLQ STO22 questionnaire: The QoL analyses will include QoL mean values, QoL response and time to symptom deterioration (TTSD) defined as the time interval between randomization and the first decrease by ≥ 10-points. All randomly assigned patients with a baseline and at least one post-baseline assessment will be included in TTSD analyses. Patients without observed deterioration will be censored at the time of their last QoL assessment., Post-operative morbidity/mortality at day 30 after surgery acc. to Clavien–Dindo classification., Post-operative Pain according to VAS (visual analog scale): The patient´s assessment of their current level of pain on a 100-mm horizontal VAS. The left-hand extreme of the line should be described as “no pain” and the right-hand as “unbearable pain”.

Source: https://euclinicaltrials.eu/ctis-public/view/2024-517300-10-01